EU clinical trial 2024-518122-33-00: Genotype-guided strategy for antithrombotic treatment versus conventional clopidogrel therapy in peripheral arterial disease (GENPAD)
Sponsor: Radboud universitair medisch centrum Stichting (Hospital/Clinic/Other health care facility). Phase: Therapeutic use (Phase IV). Countries: Netherlands (ended).
Therapeutic area(s): Diseases [C] - Cardiovascular Diseases [C14]
Gender: Female, Male. Age: 18-64 years, 65+ years. Enrolment: 2276.
Status: Ended. Start date (EU): 2024-12-13. End date (EU): 2025-05-06. Decision date: 2024-12-13. Results received: No. Last updated: 2024-12-13.

Condition(s): Peripheral Arterial Disease
Product: ACETYLSALICYLIC ACID, CLOPIDOGREL, RIVAROXABAN

Primary endpoint: The primary outcome is the occurrence of adverse clinical events related to arterial thrombosis at 24 months, including death from any cause, major adverse cardiovascular events (MACE) and major adverse limb events (MALE).

Source: https://euclinicaltrials.eu/ctis-public/view/2024-518122-33-00